EU clinical trial 2024-520077-12-00: A Study of NTX-1088 as Monotherapy and Combined with Pembrolizumab
Protocol code: NTX-1088-01
Sponsor: Nectin Therapeutics Ltd. (Pharmaceutical company). Phase: Human Pharmacology (Phase I)- First administration to humans. Countries: Poland (ongoing, recruiting).
Therapeutic area(s): Not possible to specify
Gender: Female, Male. Age: 18-64 years, 65+ years. Enrolment: 10.
Status: Ongoing, recruiting. Start date (EU): 2025-09-15. Decision date: 2025-07-07. Results received: No. Last updated: 2026-06-04.

Condition(s): Patients with Advanced Solid Malignancies

Source: https://euclinicaltrials.eu/ctis-public/view/2024-520077-12-00